EU clinical trial 2023-508135-30-00: Phase 2a Study of ZW25 in Combination with Palbociclib Plus Fulvestrant
Protocol code: ZWI-ZW25-202
Sponsor: Jazz Pharmaceuticals Ireland Limited (Pharmaceutical company). Phase: Therapeutic exploratory (Phase II). Countries: Spain (ended).
Therapeutic area(s): Diseases [C] - Neoplasms [C04]
Gender: Female, Male. Age: 18-64 years, 65+ years. Enrolment: 86.
Status: Ended. Start date (EU): 2019-12-09. End date (EU): 2025-06-30. Decision date: 2024-09-16. Results received: Yes. Last updated: 2025-03-25.

Condition(s): Breast cancer patients including those with locally advanced (unresectable) or metastatic HER2-positive, HR-positive breast cancer
Product: IBRANCE 125 mg hard capsules, IBRANCE 125 mg hard capsules, IBRANCE 125 mg hard capsules, Faslodex 250 mg solution for injection., JZP598

Primary endpoint: Part 1 Frequency of dose-limiting toxicities (DLTs) Frequency and severity of adverse events (AEs) Frequency of serious adverse events (SAEs) and deaths Frequency and severity of clinical laboratory abnormalities Frequency of electrocardiogram (ECG) and left ventricular ejection fraction (LVEF) abnormalities, Frequency and severity of adverse events of special interest (AESIs), including absolute decreases in LVEF maior or equal 10 percentage points from baseline, symptomatic heart failure, infusion-related reactions, and all maior and equal Grade 2 events of pneumonitis and/or interstitial lung disease, including pulmonary fibrosis, Frequency of dose reductions of ZW25 Frequency of dose reductions of components of combination therapy Frequency of treatment discontinuations due to adeverse event (AEs)., Part 2 Progression-free survival 6 (PFS6, defined as the % of modified intent to treat (mITT)subjects with PFS 24 weeks)
Endpoint(s): Part 1 Serum concentrations of ZW25 as a function of time post-dosing PK parameters for single (first) dose and multiple doses of ZW25 Frequency, duration, and time of onset of anti-drug antibodies (ADA) and neutralizing antibodies, if applicable, Part 2 Objetive response rate (ORR) Duration of response (DOR) Disease control rate (DCR) Progression-free survival (PFS) Overall Survival (OS) Frequency and severity of AEs Frequency of SAEs and deaths Frequency and severity of clinical laboratory abnormalities Frequency of ECG and LVEF abnormalities, Frequency and severity of AESIs, including decreases in LVEF mayor or equal 10% points from baseline),symptomatic heart failure all mayor or equal Grade 3 infusion-related reactions, and all Grade 2 events of pneumonitis and/or interstitial lung disease, including pulmonary fibrosis Frequency of dose reductions of ZW25 Frequency of dose reductions of components of combination therapy Frequency of treatment discontinuations due to AEs, Frequency of dose reductions of ZW25 Frequency of dose reductions of components of combination therapy, Frequency of treatment discontinuations due to AEs Serum concentrations of ZW25 as a function of time post-dosing PK parameters for single (first) dose and multiple doses of ZW25 Frequency, duration, and time of onset of ADA and neutralizing antibodies, if applicable

Source: https://euclinicaltrials.eu/ctis-public/view/2023-508135-30-00